EU clinical trial 2024-513112-99-00: A Multi-Center, Randomized, Double-Blind, and Placebo-Controlled Phase 3 Study to Evaluate the Efficacy and Safety of Zasocitinib (TAK-279) in Subjects with Active Psoriatic Arthritis Stratified by Prior Biologic Use (LATITUDE-PsA-3002)
Protocol code: TAK-279-PsA-3002
Sponsor: Takeda Development Center Americas Inc. (Pharmaceutical company). Phase: Therapeutic confirmatory (Phase III). Countries: Spain (ongoing, recruiting), Germany (ongoing, recruiting), Poland (ongoing, recruiting), France (ongoing, recruiting).
Therapeutic area(s): Diseases [C] - Musculoskeletal Diseases [C05]
Gender: Female, Male. Age: 18-64 years, 65+ years. Enrolment: 194.
Status: Ongoing, recruiting. Start date (EU): 2025-06-13. Decision date: 2025-05-05. Results received: No. Last updated: 2026-03-13.
Decision dates by country: ES: 2025-05-07, FR: 2025-05-05, DE: 2025-05-06, PL: 2025-08-12

Condition(s): Active Psoriatic Arthritis Stratified by Prior Biologic Use
Product: Matching Placebo for TAK-279 Dose B, ZASOCITINIB, ZASOCITINIB, Matching Placebo for TAK-279 Dose A

Primary endpoint: ACR20 response: Assessed as proportion of subjects achieving ACR20 at Week 16.
Endpoint(s): Key Secondary End Points_1_Zasocitinib Dose A vs. Placebo • Minimal disease activity (MDA): Assessed as proportion of subjects achieving MDA status at Week 16. • Psoriasis Area and Severity Index (PASI)75 response (in subjects with a baseline ≥3% body surface area [BSA]): Assessed as proportion of subjects achieving ≥75% improvement from baseline in PASI score at Week 16., Key Secondary End Points_1_Cont... • ACR50 response: Assessed as proportion of subjects achieving ACR50 at Week 16. • Change from baseline in the Health Assessment Questionnaire-Disability Index (HAQ-DI) score at Week 16. • ACR70 response: Assessed as proportion of subjects achieving ACR70 at Week 16., Key Secondary End Points_1_Cont... • Change from baseline in the Short Form Survey-36 item (SF-36) v2.0 physical component summary (PCS) score at Week 16. • Change from baseline in the Functional Assessment of Chronic Illness Therapy (FACIT)-Fatigue score at Week 16., Key Secondary End Points_2_Zasocitinib Dose B vs. Placebo • MDA: Assessed as proportion of subjects achieving MDA status at Week 16. • ACR50 response: Assessed as proportion of subjects achieving ACR50 at Week 16., Key Secondary End Points_2_Cont...• Change from baseline in the HAQ-DI score at Week 16. • ACR70 response: Assessed as proportion of subjects achieving ACR70 at Week 16. • PASI75 response (in subjects with a baseline ≥3% BSA): Assessed as proportion of subjects achieving ≥75% improvement from baseline in PASI score at Week 16., Secondary End Points_1_ Zasocitinib Dose A vs. Placebo Zasocitinib Dose B vs. Placebo • Enthesitis resolution in subjects with enthesitis at baseline (Leeds Enthesitis Index [LEI]>0): Assessed as proportion of subjects meeting LEI=0 at Week 16. • Change from baseline in individual components of ACR response at Week 16., Secondary End Points_1_ Cont... • • Dactylitis resolution in subjects with dactylitis (Leeds Dactylitis Index [LDI] Basic >0) at baseline: Assessed as proportion of subjects meeting LDI Basic=0 at Week 16. • PASI75 response (in subjects with ≥3% BSA at baseline) at Week 4. • PASI75 response (in subjects with ≥3% BSA at baseline) at Week 8., Secondary End Points_1_ Cont... • PASI90 response (in subjects with ≥3% BSA at baseline) at Week 16. • PASI100 response (in subjects with ≥3% BSA at baseline) at Week 16. • ACR50 and PASI100 response (in subjects with ≥3% BSA at baseline): Assessed as proportion of subjects simultaneously achieving ACR50 and PASI100 at Week 16., Secondary End Points_1_ Cont... • Static physician’s global assessment (sPGA) 0/1 response (in subjects with baseline sPGA ≥2): Assessed as proportion of subjects achieving an sPGA of clear (0) or almost clear (1) with a ≥2-point decrease from baseline at Week 16., Secondary End Points_1_ Cont...• HAQ-DI response: Assessed as proportion of HAQ-DI minimal clinically important differences responders (defined as achieving a clinically meaningful reduction of ≥0.35 from baseline) at Week 16., Secondary End Points_1_ Cont...• Change from baseline in the SF-36 v2.0 mental component summary score at Week 16. • Change from baseline in Psoriatic Arthritis Impact of Disease-12 items total score at Week 16., Secondary End Points_1_ Cont...• Change from baseline in Disease Activity Index for Psoriatic Arthritis score at Week 16. • Change from baseline in Disease Activity Score-28[C-reactive protein] score at Week 16. • Change from baseline in physician’s global assessment of fingernail psoriasis (PGA-F) score in subjects with psoriatic nail involvement (PGA-F>0) at baseline at Week 16., Secondary End Points_2_Zasocitinib Dose B vs. Placebo • Change from baseline in the SF-36 v2.0 PCS score at Week 16. • Change from baseline in the FACIT Fatigue score at Week 16., Secondary End Points_1_Continued_ • Enthesitis resolution in subjects with enthesitis (SPARCC Enthesitis Index >0) at baseline: Assessed as proportion of subjects meeting SPARCC Enthesitis Index=0 through Week 16. • ACR20 response: Assessed as proportion of subjects achieving ACR20 at Week 8.

Source: https://euclinicaltrials.eu/ctis-public/view/2024-513112-99-00